EU clinical trial 2024-516022-63-00: I2BIO-HD. Innovative Imaging and cognitive BIOmarkers to predict Huntington’s Disease progression
Protocol code: APHP210360
Sponsor: Assistance Publique Hopitaux De Paris (Hospital/Clinic/Other health care facility). Phase: Therapeutic confirmatory (Phase III). Countries: France (ongoing, recruiting).
Therapeutic area(s): Diseases [C] - Congenital, Hereditary, and Neonatal Diseases and Abnormalities [C16]
Gender: Female, Male. Age: 18-64 years. Enrolment: 100.
Status: Ongoing, recruiting. Start date (EU): 2024-03-21. Decision date: 2024-11-06. Results received: No. Last updated: 2025-09-17.

Condition(s): Patients with symptomatic and pre-symptomatic Huntington's disease
Product: [18F]MNI-659

Primary endpoint: The primary endpoint will be effect size, assessed by the standardized mean difference (Cohen's d) for each biomarker between the values measured initially and their assessment at 2-year follow-up.
Endpoint(s): Analysis of patient profiles and progression trajectories, taking into account all available data at D0, M1, M1 bis, M12, M24 and M24 bis, will be based on socio-demographic characteristics, as well as initial clinical and paraclinical scores and their evolution over time. Clustering analyses will use statistical validation indices to determine the optimal number of clusters and provide information on cluster quality., Identification of the best biomarkers predicting an unfavorable disease course will be carried out using conventional regression and machine learning methods. Discrimination and calibration performances will be systematically evaluated and compared for each of the models constructed.

Source: https://euclinicaltrials.eu/ctis-public/view/2024-516022-63-00